EU clinical trial 2024-511567-28-01: A Phase II Open Label Study of Brentuximab Vedotin in Combination with CHEP in Patients with Previously Untreated CD30-expressing Peripheral T-cell Lymphomas (PTCL)
Protocol code: CLSG-PTCL-CHEPA
Sponsor: Kooperativni Lymfomova Skupina z.s. (Patient organisation/association). Phase: Therapeutic exploratory (Phase II). Countries: Czechia (authorised, recruitment pending).
Therapeutic area(s): Analytical, Diagnostic and Therapeutic Techniques and Equipment [E] - Therapeutics [E02]; Diseases [C] - Hemic and Lymphatic Diseases [C15]
Gender: Female, Male. Age: 18-64 years, 65+ years. Enrolment: 33.
Status: Authorised, recruitment pending. Decision date: 2024-08-27. Results received: No. Last updated: 2024-08-27.

Condition(s): Cancer
Product: ETOPOSIDE, DOXORUBICIN, CYCLOPHOSPHAMIDE, PREDNISONE, ADCETRIS 50 mg powder for concentrate for solution for infusion

Primary endpoint: Primary Endpoint 1. PET-negative complete response (CR) rate at the end of treatment
Endpoint(s): Key Secondary Endpoints 2. Type, incidence, severity, seriousness, and relatedness of treatment emergent adverse events. 3. Type, incidence, severity, seriousness, and relatedness of adverse events in the follow-up period. Secondary Endpoints 1. Progression-free survival (PFS) 2. Overall survival (OS) 3. Event-free survival (EFS) 4. Objective Response Rate (ORR) at the end of treatment 5. Rate of pre-planned upfront HDT/ASCT 6. Duration of response (DoR) Exploratory Endpoints 1. Descript

Source: https://euclinicaltrials.eu/ctis-public/view/2024-511567-28-01